EU clinical trial 2024-519892-24-00: EFFICACY OF SUPRASPINATUS NERVE APPROACH THROUGH CORTICOSTEROID ADMINISTRATION VERSUS PULSED RADIOFREQUENCY IN CHRONIC SHOULDER PAIN. DOUBLE-BLIND RANDOMIZED CLINICAL TRIAL.
Sponsor: Fundacio Institut De Recerca De L'Hospital De La Santa Creu I Sant Pau (Hospital/Clinic/Other health care facility). Phase: Therapeutic confirmatory (Phase III). Countries: Spain (ongoing, recruiting).
Therapeutic area(s): Analytical, Diagnostic and Therapeutic Techniques and Equipment [E] - Therapeutics [E02]; Analytical, Diagnostic and Therapeutic Techniques and Equipment [E] - Anesthesia and Analgesia [E03]; Diseases [C] - Nervous System Diseases [C10]; Diseases [C] - Musculoskeletal Diseases [C05]
Gender: Female, Male. Age: 18-64 years, 65+ years. Enrolment: 76.
Status: Ongoing, recruiting. Start date (EU): 2025-01-15. Decision date: 2025-01-15. Results received: No. Last updated: 2025-01-15.

Condition(s): Chronic shoulder pain
Product: TRIGON DEPOT 40 mg/ml suspensión inyectable.

Primary endpoint: The SPADI (Shoulder Pain and Disability Index) is a quality-of-life questionnaire designed to evaluate pain and disability related to shoulder pathology.
Endpoint(s): Demographics, Comorbidity, Visual Analog Scale (VAS), Numerical Verbal Scale (NVS), Range of Motion, Amount of Analgesics Administered, Hospital Anxiety and Depression Scale (HAD), EuroQol 5D (EQ-5D), Medical Outcomes Study Sleep Scale (MOS), Satisfaction Assessment

Source: https://euclinicaltrials.eu/ctis-public/view/2024-519892-24-00